EU clinical trial 2022-501160-18-00: Randomised, crossover bioequivalence clinical trial of pregabalin 300 mg tablets versus pregabalin 300 mg hard capsules, after a single oral dose administration to healthy volunteers under fasting conditions.
Protocol code: N-PRE-22-273
Sponsor: Laboratorios Normon S.A. (Pharmaceutical company). Phase: Human Pharmacology (Phase I)- Bioequivalence Study. Countries: Spain (ended).
Therapeutic area(s): Not possible to specify
Gender: Female, Male. Age: 18-64 years. Enrolment: 24.
Status: Ended. Start date (EU): 2022-09-22. End date (EU): 2022-10-27. Decision date: 2022-09-19. Results received: Yes. Last updated: 2022-09-19.

Condition(s): Healthy volunteers
Product: Lyrica 300 mg hard capsules, Pregabalina Normon 300 mg comprimidos

Primary endpoint: AUC0-t, Cmax
Endpoint(s): AUC0-∞, Tmax

Source: https://euclinicaltrials.eu/ctis-public/view/2022-501160-18-00